EU clinical trial 2024-513357-74-01: Phase 0 trial of CBD in recurrent glioblastoma patients
Protocol code: CBD in GBM
Sponsor: Erasmus Universitair Medisch Centrum Rotterdam (Erasmus MC) (Hospital/Clinic/Other health care facility). Phase: Human Pharmacology (Phase I)- Other. Countries: Netherlands (ongoing, recruiting).
Therapeutic area(s): Diseases [C] - Nervous System Diseases [C10]
Gender: Female, Male. Age: 18-64 years, 65+ years. Enrolment: 7.
Status: Ongoing, recruiting. Start date (EU): 2025-08-04. Decision date: 2024-10-22. Results received: No. Last updated: 2025-07-30.

Condition(s): Glioblastoma

Source: https://euclinicaltrials.eu/ctis-public/view/2024-513357-74-01